EU clinical trial 2023-508735-31-00: IMPAHCT-FUL: A Long-Term Extension, Multi-Center Safety Study of AV-101 in Subjects With Pulmonary Arterial Hypertension (PAH) Who Have Completed Study AV-101-002
Protocol code: AV-101-003
Sponsor: Aerovate Therapeutics Inc. (Pharmaceutical company). Phase: Therapeutic confirmatory (Phase III). Countries: Portugal (ended), Italy (ended), Sweden (ended), Czechia (ended), Ireland (ended), France (ended), Spain (ended), Poland (ended), Latvia (ended), Belgium (ended), Netherlands (ended), Austria (ended), Greece (ended), Germany (ended).
Therapeutic area(s): Diseases [C] - Cardiovascular Diseases [C14]
Gender: Female, Male. Age: 18-64 years, 65+ years. Enrolment: 205.
Status: Ended. Start date (EU): 2023-05-05. End date (EU): 2024-07-18. End date: 2024-08-08. Decision date: 2024-03-12. Results received: Yes. Last updated: 2024-06-03.
Decision dates by country: AT: 2024-04-08, BE: 2024-03-27, CZ: 2024-03-14, FR: 2024-03-13, DE: 2024-03-14, GR: 2024-06-03, IE: 2024-03-12, IT: 2024-03-21, LV: 2024-03-12, PT: 2024-03-13, ES: 2024-03-13, SE: 2024-03-13, NL: 2024-03-12, PL: 2024-03-20

Condition(s): Pulmonary Arterial Hypertension (PAH)

Primary endpoint: Safety and tolerability of AV-101, Change from baseline in the 6MWD, Change from baseline in NT-proBNP, Time to Clinical Worsening events, Change from baseline in Transthoracic Echo parameters of right ventricular (RV) function

Source: https://euclinicaltrials.eu/ctis-public/view/2023-508735-31-00